EU clinical trial 2023-505729-15-00: Evaluation of the safety of inhaled sedation with Isoflurane in head trauma patients.
Sponsor: Centre Hospitalier Universitaire Grenoble Alpes (Hospital/Clinic/Other health care facility). Phase: Therapeutic exploratory (Phase II). Countries: France (ongoing, recruiting).
Therapeutic area(s): Analytical, Diagnostic and Therapeutic Techniques and Equipment [E] - Anesthesia and Analgesia [E03]
Gender: Female, Male. Age: 18-64 years, 65+ years. Enrolment: 30.
Status: Ongoing, recruiting. Start date (EU): 2024-06-20. Decision date: 2023-08-23. Results received: No. Last updated: 2026-03-27.

Condition(s): Head trauma patient

Source: https://euclinicaltrials.eu/ctis-public/view/2023-505729-15-00